EU clinical trial 2022-500782-27-00: A phase I/II open label, multicenter study evaluating the feasibility, safety and efficacy of point-of-care manufactured antiBCMA CAR T cells (GLPG5301; BCMACP03) in subjects with relapsed/refractory Multiple Myeloma (RRMM)
Protocol code: CP0301-MM
Sponsor: Lakefront Biotherapeutics (Pharmaceutical company). Phase: Phase I and Phase II (Integrated)- First administration to humans. Countries: Belgium (ended), Netherlands (ended).
Therapeutic area(s): Diseases [C] - Congenital, Hereditary, and Neonatal Diseases and Abnormalities [C16]
Gender: Female, Male. Age: 18-64 years, 65+ years. Enrolment: 41.
Status: Ended. Start date (EU): 2023-11-14. End date (EU): 2026-05-22. Decision date: 2023-01-31. Results received: No. Last updated: 2026-06-04.
Decision dates by country: BE: 2023-01-31, NL: 2023-03-24

Condition(s): relapsed/refractory Multiple Myeloma
Product: BCMACP03

Primary endpoint: Phase I dose-escalation phase: Incidence of (serious) adverse events ([S]Aes), Dose-limiting toxicities (DLTs) until Day 28, Phase II dose-expansion phase: Objective response (OR) until 2 years post GLPG5301 infusion per International Myeloma Working Group (IMWG) criteria
Endpoint(s): Type, frequency and severity of (S)AEs (including AEs of special interest [AESI]) and clinically significant laboratory abnormalities, Best overall response (BOR) until 2 years post GLPG5301 infusion per IMWG criteria, Complete response (CR) until 2 years post GLPG5301 infusion per IMWG criteria, Progression-free survival (PFS), Duration of response (DOR), Overall survival (OS), Minimal Residual Disease (MRD), Soluble BCMA (sBCMA) levels, Time to Response (TTR), in subjects with a response, Levels of GLPG5301 in blood at peak and over time, Levels of chemokines and cytokines in serum over time, Number of successfully manufactured GLPG5301 products within the predefined release specifications, Change from baseline in measurement of health-related QoL as assessed using the European Organization for Research and Treatment of Cancer (EORTC) QLQ-C30, EQ-5D-5L, and EORTC QLC-MY20

Source: https://euclinicaltrials.eu/ctis-public/view/2022-500782-27-00